EU clinical trial 2025-523972-21-00: Study of IBI3009 alone or in combination with other therapies for extensive-stage small cell lung cancer
Protocol code: CIBI3009A101
Sponsor: Fortvita Biologics (USA) Inc. (Hospital/Clinic/Other health care facility). Phase: Phase I and Phase II (Integrated)- First administration to humans. Countries: Poland (authorised, recruitment pending), Denmark (authorised, recruitment pending), Spain (authorised, recruitment pending).
Therapeutic area(s): Diseases [C] - Respiratory Tract Diseases [C08]; Diseases [C] - Neoplasms [C04]
Gender: Female, Male. Age: 18-64 years, 65+ years. Enrolment: 30.
Status: Authorised, recruitment pending. Decision date: 2026-04-27. Results received: No. Last updated: 2026-05-13.
Decision dates by country: DK: 2026-04-27, PL: 2026-04-30, ES: 2026-05-13

Condition(s): Extensive-Stage Small Cell Lung Cancer

Source: https://euclinicaltrials.eu/ctis-public/view/2025-523972-21-00